EU clinical trial 2023-507402-13-00: A randomized phase III trial assessing iberdomide versus iberdomide plus isatuximab maintenance therapy post autologous hematopoietic stem-cell transplantation in patients with newly diagnosed multiple myeloma (GMMG-HD9/DSMM XVIII-trial)
Protocol code: GMMG-HD9/DSMM XVIII
Sponsor: Universitaetsklinikum Heidelberg AöR (Hospital/Clinic/Other health care facility). Phase: Therapeutic confirmatory (Phase III). Countries: Germany (ongoing, recruiting), Austria (authorised, recruitment pending).
Therapeutic area(s): Diseases [C] - Hemic and Lymphatic Diseases [C15]; Diseases [C] - Neoplasms [C04]
Gender: Female, Male. Age: 18-64 years, 65+ years. Enrolment: 451.
Start date (EU): 2024-04-03. Decision date: 2024-02-16. Results received: No. Last updated: 2025-07-09.
Decision dates by country: AT: 2025-01-17, DE: 2024-02-16

Condition(s): Multiple myeloma
Product: Dexamethason TAD® 20 mg Tabletten, Iberdomide, Iberdomide, Iberdomide, Iberdomide, Isatuximab

Primary endpoint: Rates of NGF-MRD negativity (sensitivity 2x10-6, from bone marrow aspirate [BMA]) after two years of maintenance therapy.
Endpoint(s): PFS, defined as time from randomization to disease progression or death from any cause, whichever occurs first.

Source: https://euclinicaltrials.eu/ctis-public/view/2023-507402-13-00